EU clinical trial 2024-515237-15-00: NRG-HN009: RANDOMIZED PHASE II/III TRIAL OF RADIATION WITH CISPLATIN AT 100 MG/M2 EVERY THREE WEEKS VERSUS RADIATION WITH WEEKLY CISPLATIN AT 40 MG/M2 FOR PATIENTS WITH LOCOREGIONALLY ADVANCED SQUAMOUS CELL CARCINOMA OF THE HEAD AND NECK (SCCHN).
Sponsor: Cancer Trials Ireland (Patient organisation/association). Phase: Phase II and Phase III (Integrated). Countries: Ireland (temporarily halted).
Therapeutic area(s): Diseases [C] - Neoplasms [C04]
Gender: Female, Male. Age: 18-64 years, 65+ years. Enrolment: 78.
Status: Temporarily halted. Start date (EU): 2025-01-21. Decision date: 2024-10-03. Results received: No. Last updated: 2026-03-23.

Condition(s): Advanced head and neck cancer
Product: Cisplatin 1 mg/ml Concentrate for Solution for Infusion, Cisplatin 1 mg/ml Concentrate for Solution for Infusion

Primary endpoint: Phase II Primary Endpoint: Acute toxicity, as measured by the T-scores., Phase III Primary Endpoints: • Primary: Overall Survival (OS)., Co-primary: Acute toxicity, as measured by the T-scores.
Endpoint(s): Locoregional failure., Distant metastasis., Progression-Free Survival (PFS)., 3-year restricted mean survival time (RMST) for OS and PFS (if longterm update is warranted)., Acute toxicity, as measured by CTCAE v5.0., Late toxicity, as measured by CTCAE v5.0., Late toxicity, as measure by the A-scores., Quality of life, as measured by FACT-H&N., Hearing loss, as measured by HHIA-S., Hearing loss (cochleotoxicity), as measured by audiograms and the modified TUNE grading scale., Speech audiometry Consonant-Nucleus-Consonant word scores and tympanometry (subject to the modified TUNE grading scale testing results; otherwise, it will be an exploratory endpoint).

Source: https://euclinicaltrials.eu/ctis-public/view/2024-515237-15-00